EU clinical trial 2026-525701-12-00: Evaluating cognitive effects of a three month course of methylphenidate in Parkinson's disease patients with mild cognitive impairment.
Sponsor: Universidad Rey Juan Carlos (Educational Institution). Phase: Therapeutic exploratory (Phase II). Countries: Spain (not authorised).
Therapeutic area(s): Analytical, Diagnostic and Therapeutic Techniques and Equipment [E] - Therapeutics [E02]; Psychiatry and Psychology [F] - Behavior and Behavior Mechanisms [F01]; Phenomena and Processes [G] - Physiological processes [G07]
Gender: Female, Male. Age: 18-64 years, 65+ years. Enrolment: 40.
Status: Not authorised. Decision date: 2026-06-08. Results received: No. Last updated: 2026-06-08.

Condition(s): Parkinson's disease
Product: Methylphenidate Viatris 10 mg tabletten, saccharine tablets

Primary endpoint: Electrophysiological markers, Neuropsychological evaluation, UPDRS II and III, PDQ-8 (Parkinson’s disease Questionnaire)

Source: https://euclinicaltrials.eu/ctis-public/view/2026-525701-12-00